EU clinical trial 2024-517079-19-00: MR-Spectroscopy: Investigating neurochemical changes in brain metabolism in migraineurs before and after CGRP-Antibody treatment – a randomized, controlled, open-label trial.
Protocol code: MRSI
Sponsor: Medizinische Universitaet Innsbruck (Educational Institution). Phase: Therapeutic use (Phase IV). Countries: Austria (ended).
Therapeutic area(s): Diseases [C] - Nervous System Diseases [C10]
Gender: Female, Male. Age: 18-64 years. Enrolment: 38.
Status: Ended. Start date (EU): 2022-02-21. End date (EU): 2025-10-20. Decision date: 2024-10-30. Results received: No. Last updated: 2024-10-30.

Condition(s): migraine
Product: AJOVY 225 mg solution for injection in pre-filled syringe

Primary endpoint: Difference in neurotransmitter level in the occipital cortex before and after 12 weeks of CGRP antibody treatment in the interventional group compared to the control group assessed by MR spectroscopy at baseline and FU visit 3.
Endpoint(s): Comparison of neurochemical/metabolic changes between study participants with migraine with and without aura., Change in migraine frequency and intensity over the treatment period assessed by MIDAS and HIT 6 questionnaire, Correlation between the neurochemical changes and the clinical symptoms (e.g. migraine frequency, intensity or duration)

Source: https://euclinicaltrials.eu/ctis-public/view/2024-517079-19-00